EU clinical trial 2023-506437-29-00: GLP-1 receptor agonists as preventive treatment of diabetes after renal transplantation: randomized clinical trial. Study 1: Immediate Kidney Transplant Recipients
Sponsor: Bellvitge University Hospital, Fundacio Institut D'Investigacio Biomedica De Bellvitge IDIBELL (Hospital/Clinic/Other health care facility, Laboratory/Research/Testing facility). Phase: Therapeutic confirmatory (Phase III). Countries: Spain (ongoing, recruitment ended).
Therapeutic area(s): Diseases [C] - Nutritional and Metabolic Diseases [C18]
Gender: Female, Male. Age: 18-64 years, 65+ years. Enrolment: 128.
Status: Ongoing, recruitment ended. Start date (EU): 2023-12-19. Decision date: 2023-12-04. Results received: No. Last updated: 2025-09-12.

Condition(s): Preventive treatment of post-kidney transplant diabetes
Product: Trulicity 0.75 mg solution for injection in pre-filled pen

Primary endpoint: Proportion of patients with prediabetes and diabetes at 3 months after transplant, defined as one of the following criteria of the American Diabetes Association: - patients have a fasting glucose ≥126 mg/dL (7.0 mmol/L), - patients with an abnormal oral glucose tolerance test (OGTT) (value 2-h plasma glucose ≥200 mg/dL (11.1 mmol/L). The test will be carried out according to as described by the WHO, using a glucose load containing the equivalent of 75 g of anhydrous glucose dissolved in water,
Endpoint(s): Number and type of additional drugs aimed at diabetes control and metabolic control (HbA1c) and hypoglycemic episodes (defined as ≤ 70 mg/dl) at 3 and 12 months after RT., Insulin sensitivity as measured by homeostatic model assessment calculated for insulin resistance score (HOMA-IR): HOMA-IR = [glucose (nmol/L) * insulin (μU/mL)/22.5], using fasting values and HOMA-measured β-cell function of the β-cell function index (HOMA-B) calculated as the product of 20 and basal insulin levels divided by the value of the basal glucose concentrations minus 3.5 at 3, 6, and 12 months., Weight change measured in kilograms (Kg) and BMI variations from pre-transplant to 3 and 12 months of follow-up; waist circumference and waist-hip circumference ratio measured per cm from pre-transplant to 3 and 12-month follow-up, Renal function assessed by routine blood tests: serum creatinine (sCr), estimated glomerular filtration rate (eGFR) (measured by CKD-EPI formulas) and proteinuria measured by spot urine albumin/creatinine ratio (at 3 and 12 months), Lipid profile by routine blood tests: LDL (low-density lipoprotein) cholesterol, HDL (high-density lipoprotein) cholesterol, and triglycerides from pre-transplant to 3 and 12-month follow-up, Incidence of death and death-censored graft loss, Renal biopsy lesions at 12 months: volume fractions of mesangium and mesangial matrix, mesangial expansion (%), Analysis of the differences in the levels of immunosuppression (tacrolimus) in the GLP-1RA group. We will perform the level analysis using the pre-dose concentration of TAC at first steady state (5-7 days after onset), 15 days, 1 and 3 months. We will compare the concentration in blood of the dose standardized CT. Different genotype states of CYP3A4*22 and CYP3A5*3, and P-glycoprotein (3435CT, ABCB1) will be considered in the analysis., Rate of treatment interruptions as well as acute rejection episodes (Biopsy-proven Acute Rejection and Treated Acute Rejection), infection and cardiovascular events, Proportion of patients with prediabetes and diabetes at 12 months after transplant.

Source: https://euclinicaltrials.eu/ctis-public/view/2023-506437-29-00